EU clinical trial 2023-504230-21-00: A blinded randomized study of neostigmine/glycopyrrolate 50 mikrogram/kg or sugammadex 2 mg/kg for reversal of neuromuscular blockade in elderly patients (≥ 75 years)
Sponsor: Rigshospitalet (Hospital/Clinic/Other health care facility). Phase: Therapeutic use (Phase IV). Countries: Denmark (ended).
Therapeutic area(s): Analytical, Diagnostic and Therapeutic Techniques and Equipment [E] - Anesthesia and Analgesia [E03]
Gender: Female, Male. Age: 65+ years. Enrolment: 1.
Status: Ended. Start date (EU): 2024-08-12. End date (EU): 2025-05-04. Decision date: 2023-06-07. Results received: No. Last updated: 2025-03-12.

Condition(s): Anaesthesia to laparoscopic robotassisted surgery
Product: Robinul-Neostigmin, injektionsvæske, opløsning, Bridion 100 mg/mL solution for injection

Primary endpoint: Time to TOF > 0.9 (from beginning of administration of reversal agent until TOF > 0.9)
Endpoint(s): • Key secondary outcome is sign of residual neuromuscular blockade within 90 minutes after administration of reversal agent defined as a composite (assessed upon arrival at PACU after 20 minutes and after 90 minutes) of either o Hand grip strength for 5 seconds or o Occurrence of double vision/blurred vision (yes/no) or o Ability to track objects with eyes (follow finger of examiner) (yes/no) or o Ability to sustain head lift for 5 seconds (yes/no) or o Ability to protrude the tongue for 5 seco, • Occurrence of episodes of desaturation defined as more than 3 minutes with spO2 < 88%, • New cardiac arrythmias (bradycardia or tachycardia defined as atrial fibrillation, atrial flutter, sinus tachycardia (>95 bpm), sinus bradycardia (<45 bpm)) within 180 minutes after administration of reversal agent, • Occurrence of reintubation, • Time from administration of reversal agent to patient is ready to leave the operating room

Source: https://euclinicaltrials.eu/ctis-public/view/2023-504230-21-00